EU clinical trial 2023-506402-39-00: A Study of HFB301001 in Adult Patients With Advanced Solid Tumors
Protocol code: HFB-301001-01
Sponsor: Hifibio Inc. (Pharmaceutical company). Phase: Human Pharmacology (Phase I)- First administration to humans. Countries: Spain (ended).
Therapeutic area(s): Diseases [C] - Neoplasms [C04]
Gender: Female, Male. Age: 18-64 years, 65+ years. Enrolment: 70.
Status: Ended. Start date (EU): 2022-07-27. End date (EU): 2025-10-13. Decision date: 2023-08-30. Results received: No. Last updated: 2025-03-12.

Condition(s): Advanced cancer of different organs

Source: https://euclinicaltrials.eu/ctis-public/view/2023-506402-39-00